EU clinical trial 2024-511795-32-00: A Phase 3 Open-Label Study of Danicopan as Add-on Treatment to Ravulizumab or Eculizumab in Pediatric Participants with Paroxysmal Nocturnal Hemoglobinuria Who Have Clinically Significant Extravascular Hemolysis
Protocol code: ALXN2040-PNH-302
Sponsor: Alexion Pharmaceuticals Inc. (Pharmaceutical company). Phase: Therapeutic confirmatory (Phase III). Countries: France (ongoing, recruiting), Germany (authorised, recruitment pending).
Therapeutic area(s): Diseases [C] - Hemic and Lymphatic Diseases [C15]
Gender: Female, Male. Age: 0-17 years. Enrolment: 2.
Start date (EU): 2025-02-11. Decision date: 2024-12-16. Results received: No. Last updated: 2026-07-08.
Decision dates by country: FR: 2024-12-16, DE: 2026-07-08

Condition(s): Paroxysmal Nocturnal Hemoglobinuria
Product: ALXN 2040, ALXN 2040

Primary endpoint: Change from Baseline in Hgb at Week 12
Endpoint(s): • PK parameters (Ctrough, Cmax, and accumulation ratio), • Transfusion avoidance, defined as participants who remain transfusion-free and do not require a transfusion as per protocol-specified guidelines through Weeks 12 and 24, • Change from Baseline in absolute reticulocyte count at Weeks 12 and 24, • Change from Baseline in PedsQL Generic Core Scales score at Weeks 12 and 24, • Acceptability and palatability questionnaire scores, • Change from Baseline in pediatric FACIT-Fatigue scores at Weeks 12 and 24, • Change from Baseline in Hgb at Week 24, • Change from Baseline in PD parameters (such as AP activity, Bb) during Treatment Period and LTE, • Incidence of TEAEs, SAEs, laboratory abnormalities, and events leading to discontinuation

Source: https://euclinicaltrials.eu/ctis-public/view/2024-511795-32-00